EU clinical trial 2022-500125-32-00: Reduced antithrombotic strategy for high bleeding risk patients with myocardial infarction treated with percutaneous coronary intervention - The Dan-DAPT trial
Protocol code: 2022-500125-32-00
Sponsor: Rigshospitalet (Hospital/Clinic/Other health care facility). Phase: Therapeutic use (Phase IV). Countries: Denmark (ongoing, recruiting).
Therapeutic area(s): Diseases [C] - Cardiovascular Diseases [C14]
Gender: Female, Male. Age: 18-64 years, 65+ years. Enrolment: 2700.
Status: Ongoing, recruiting. Start date (EU): 2022-06-20. Decision date: 2022-04-27. Results received: No. Last updated: 2025-11-18.

Condition(s): Myocardial infarction
Product: Efient 10 mg film-coated tablets., Efient 5 mg film-coated tablets., Brilique 90 mg film-coated tablets, ACETYLSALICYLIC ACID, CLOPIDOGREL, Prasugrel "Krka", filmovertrukne tabletter, Prasugrel Teva 5 mg Film-coated Tablets, Prasugrel Mylan 10 mg film-coated tablets, Prasugrel Teva 10 mg Film-coated Tablets, Prasugrel "Krka", filmovertrukne tabletter, Prasugrel Mylan 5 mg film-coated tablets

Primary endpoint: The primary composite endpoints are: • The NACE (net adverse clinical events) endpoint is a composite of all-cause mortality, recurrent myocardial infarc, definite stent thrombosis, ischemic stroke, and BARC type 3-5 non-access site bleedings after 12 months • Bleeding Academic Research Consortium (BARC) type 2-5 non-access site bleeding after 12 months

Source: https://euclinicaltrials.eu/ctis-public/view/2022-500125-32-00